EU clinical trial 2024-510840-30-00: EORTC-1532-GUCG: A phase 2 Randomized Open-Label Study of Oral darolutamide (ODM-201) vs. androgen deprivation therapy (ADT) with LHRH agonists or antagonist in Men with Hormone Naive Prostate Cancer.
Sponsor: European Organisation For Research And Treatment Of Cancer (Patient organisation/association). Phase: Therapeutic exploratory (Phase II). Countries: Italy (ended), Spain (ongoing, recruitment ended), France (ongoing, recruitment ended), Belgium (ongoing, recruitment ended).
Therapeutic area(s): Diseases [C] - Neoplasms [C04]
Gender: Male. Age: 18-64 years, 65+ years. Enrolment: 169.
Start date (EU): 2017-12-01. Decision date: 2024-05-23. Results received: No. Last updated: 2025-05-26.
Decision dates by country: IT: 2024-05-29, ES: 2024-05-23, FR: 2024-05-23, BE: 2024-05-27

Condition(s): Hormone Naive Prostate Cancer
Product: BAY 1841788, DEGARELIX, LEUPRORELIN, TRIPTORELIN, GOSERELIN, TRIPTORELIN PAMOATE

Primary endpoint: The primary endpoint is the PSA response assessed at 24 weeks. PSA response is defined as a ≥ 80% decline in PSA measurement taken at week 24 relative to the measurement taken at baseline, in the darolutamide study arm. The ADT arm is used as an internal control.
Endpoint(s): The main key secondary endpoint in this study is the change in hormone-treatment related symptoms scale of the EORTC QLQ-PR25 at 24 weeks compared to baseline in the darolutamide study arm. A 10-point difference is regarded as a clinically meaningful benefit., Safety according to NCI-CTC version 4.0, Objective response rate at 24 weeks in patients with RECIST 1.1 measurable disease at baseline, PSA complete response rate at 24 weeks defined as a ≥ 90% decline in PSA measurement at week 24 relative to the measurement taken at baseline

Source: https://euclinicaltrials.eu/ctis-public/view/2024-510840-30-00